EU clinical trial 2022-500197-34-01: A Phase II double-blind multi-center, placebo-controlled trial, to assess the efficacy and safety of alpelisib (BYL719) in pediatric and adult patients with Megalencephaly-CApillary malformation Polymicrogyria syndrome (MCAP)
Protocol code: SESAM
Sponsor: Centre Hospitalier Universitaire Dijon Bourgogne (Hospital/Clinic/Other health care facility). Phase: Therapeutic exploratory (Phase II). Countries: France (ongoing, recruiting).
Therapeutic area(s): Phenomena and Processes [G] - Genetic Phenomena [G05]
Gender: Female, Male. Age: 0-17 years, 18-64 years. Enrolment: 20.
Status: Ongoing, recruiting. Start date (EU): 2022-11-03. Decision date: 2022-09-22. Results received: No. Last updated: 2026-02-22.

Condition(s): Megalencephaly-CApillary malformation Polymicrogyria syndrome
Product: Alpelisib placebo, ALPELISIB

Primary endpoint: Success will be defined as an improvement of at least 4 points in the Vineland II Adaptive Behavior Scale (VABS-II) at 24 months of treatment compared to baseline. We will compare the observed proportion to the expected one
Endpoint(s): Response (yes/no) defined as an improvement of at least 4 points in the VABS-II at 6 months of treatment or placebo, compared to baseline. For this endpoint comparison will be made between the alpelisib and placebo groups., Changes in brain volume, vascularization, structural connectivity, assessed by MRI, from baseline to end of treatment period, Number, type and severity of adverse events, For exploratory study: Improvement of at least 4 points in the VABS-II at 6, 12, and 18 months of treatment, compared to baseline., For exploratory study: Evolution of quality of life (QoL) questionnaires, scores at visual analogue scale, and evolution of Clinical Global Impression of severity (CGI-S) and Global improvement scores (CGI-I) at 6, 12, 18, 24, 30 months of treatment, compared to baseline, For exploratory study: Changes in neuropsychological scales adapted to age at 12 and 24 months of treatment compared to baseline for attention, cognition, visuo-spatial disorders, fine motor skills, speech, reasoning and cognitive inhibition abilities and at 24 months of treatment compared to baseline for Intellectual Quotient (IQ) scale, For exploratory study: Changes in seizures frequency (weekly diary), and antiepileptic drugs use at 6, 12, 18 and 24 months of treatment compared to baseline, For exploratory study: Changes in overgrowth or skin lesions, classified as follow: increase, no changes or reduction according to clinical measures and evaluation of standardized photographs taken at 6, 12, 18 and 24 months of treatment compared to baseline, For exploratory study: Changes in Motor Function Measure (MFM) scores at 6, 12, 18 and 24 months of treatment compared to baseline, For exploratory study: Level of alpelisib (ng/mL) in cerebrospinal fluid (CSF) and in blood between 6 and 24 months of treatment, and correlation estimate (rho) between CSF and blood levels of alpelisib

Source: https://euclinicaltrials.eu/ctis-public/view/2022-500197-34-01